EU clinical trial 2023-504955-28-01: (22423 NIRVANA) A randomized, parallel-group treatment, Phase 2, double-blind pilot study to investigate the efficacy and safety of elinzanetant compared with placebo for treatment of sleep disturbances associated with menopause
Protocol code: 22423
Sponsor: Bayer Consumer Care AG, Bayer AG (Pharmaceutical company). Phase: Therapeutic exploratory (Phase II). Countries: Germany (ended), Austria (ended), Belgium (ended), Netherlands (ended), Poland (ended), Czechia (ended), Spain (ended).
Therapeutic area(s): Diseases [C] - Female Urogenital Diseases and Pregnancy Complications [C13]
Gender: Female. Age: 18-64 years, 65+ years. Enrolment: 84.
Status: Ended. Start date (EU): 2024-03-14. End date (EU): 2024-07-31. End date: 2024-11-08. Decision date: 2024-03-07. Results received: Yes. Last updated: 2024-12-04.
Decision dates by country: BE: 2024-03-11, ES: 2024-03-18, PL: 2024-03-15, NL: 2024-03-07, CZ: 2024-05-13, DE: 2024-03-11, AT: 2024-03-18

Condition(s): Sleep disturbances associated with menopause
Product: placebo of BAY 3427080, BAY 3427080

Primary endpoint: Change from baseline in WASO at Week 4 as measured by PSG
Endpoint(s): Change from baseline in WASO at Week 12 as measured by PSG, Change from baseline in SE at Week 4 as measured by PSG, Change from baseline in SE at Week 12 as measured by PSG, Change from baseline in PROMIS SD SF 8b total score at Week 4, Change from baseline in PROMIS SD SF 8b total score at Week 12, Change from baseline in ISI total score at Week 4, Change from baseline in ISI total score at Week 12, TEAEs, Abnormal laboratory parameters

Source: https://euclinicaltrials.eu/ctis-public/view/2023-504955-28-01